EU clinical trial 2024-520012-18-00: FOSFOMYCIN AS AN ORAL ALTERNATIVE THERAPY IN THE TREATMENT OF ACUTE BACTERIAL PROSTATITIS CAUSED BY MULTIDRUG-RESISTANT ESCHERICHIA COLI. PILOT STUDY
Sponsor: Fundacio Assistencial De Mutua De Terrassa Fpc (Hospital/Clinic/Other health care facility). Phase: Therapeutic use (Phase IV). Countries: Spain (authorised, recruitment pending).
Therapeutic area(s): Diseases [C] - Bacterial Infections and Mycoses [C01]
Gender: Male. Age: 18-64 years, 65+ years. Enrolment: 244.
Status: Authorised, recruitment pending. Decision date: 2025-01-21. Results received: No. Last updated: 2025-06-30.

Condition(s): Prostatitis aguda bacteriana (PAB) por Escherichia coli multirresitente.
Product: FOSFOMYCIN

Primary endpoint: Determinar la eficacia del tratamiento secuencial con fosfomicina-trometamol (FT) por vía oral de las prostatitis agudas bacterianas (PAB) por Escherichia coli sensibles in vitro a la fosfomicina en pacientes con estabilidad clínica y que hayan recibido entre 1 y 5 días de antibioterapia parenteral previa con un antimicrobiano con actividad in vitro.

Source: https://euclinicaltrials.eu/ctis-public/view/2024-520012-18-00